EU clinical trial 2025-521125-33-00: An Adaptive Clinical Platform Trial to Evaluate the Safety and Efficacy of COM701 as Monotherapy or Combination Therapy as Maintenance Therapy in Participants with Relapsed Platinum Sensitive Ovarian Cancer (PSOC)
Protocol code: CPG-01-201
Sponsor: Compugen Ltd. (Pharmaceutical company). Phase: Phase I and Phase II (Integrated)- Other. Countries: France (authorised, recruiting).
Therapeutic area(s): Diseases [C] - Neoplasms [C04]
Gender: Female. Age: 18-64 years, 65+ years. Enrolment: 20.
Status: Authorised, recruiting. Start date (EU): 2025-09-05. Decision date: 2025-07-29. Results received: No. Last updated: 2026-03-17.

Condition(s): Ovarian Cancer, Recurrent Ovarian Cancer
Product: SALINE

Primary endpoint: Progression free survival per investigator assessed RECIST 1.1 in COM701-treated participants compared to placebo-treated participants
Endpoint(s): Frequency of AEs and SAEs and severity per CTCAE 5.0 in COM701-treated participants compared to placebo-treated participants, Changes from baseline in safety laboratory parameters, vital signs and ECG in COM701-treated participants compared to placebo-treated participants., Time to the initiation of a new anti-cancer treatment in COM701-treated participants compared to placebo-treated participants

Source: https://euclinicaltrials.eu/ctis-public/view/2025-521125-33-00